EU clinical trial 2023-506301-20-00: A Multicenter, Open-label Study to Assess the Safety, Tolerability, Pharmacokinetics, and Effect on Seizures and Behavioral Symptoms of Radiprodil in Patients with Tuberous Sclerosis Complex (TSC) or Focal Cortical Dysplasia (FCD) Type II.
Protocol code: RAD-GRIN-201
Sponsor: Grin Therapeutics Inc. (Pharmaceutical company). Phase: Phase I and Phase II (Integrated)- Other. Countries: Spain (ongoing, recruitment ended), Poland (ongoing, recruitment ended), Italy (ongoing, recruitment ended), Netherlands (ended), Belgium (ongoing, recruitment ended).
Therapeutic area(s): Diseases [C] - Nervous System Diseases [C10]
Gender: Female, Male. Age: 0-17 years. Enrolment: 28.
Start date (EU): 2024-04-15. Decision date: 2024-01-12. Results received: No. Last updated: 2026-07-01.
Decision dates by country: NL: 2024-07-10, BE: 2024-07-30, ES: 2024-01-12, PL: 2024-01-12, IT: 2024-01-12

Condition(s): Tuberous Sclerosis Complex (TSC), Focal Cortical Dysplasia (FCD) Type II
Product: Radiprodil, Radiprodil, Radiprodil

Primary endpoint: Adverse events (AEs), serious adverse events (SAEs), and adverse drug reactions (ADRs) (frequency, type, severity, and duration) over the course of treatment (Part A and Part B) • Changes in vital signs • Physical examination findings • 12-lead electrocardiogram (ECG) findings • Clinically significant changes in laboratory parameters • Occurrence of suicidal ideation or behavior Plasma concentrations of radiprodil at predefined timepoints
Endpoint(s): Change from baseline to end of the Maintenance Period (Day 84) in seizure frequency from daily seizure electronic diary (eDiary), Change from baseline to end of Part B in seizure frequency from daily seizure eDiary, Percent change from baseline to end of treatment (Part A and Part B) in video electroencephalogram (V-EEG) seizure burden (e.g., seizure type, severity, and frequency recorded during V-EEGs), Number of seizure free days and longest period with no seizures from baseline to end of treatment, Change from baseline to end of treatment (Part A and Part B) in behavioral features as measured by the aberrant behavior checklist-community (ABC-2C), as well as other disorder features as measured by quality of life (Pediatric Quality of Life Inventory [PedsQL]), Caregiver Burden Inventory (CBI), and global impression (Caregiver Global Impression of Change [CaGI-C]), and Clinical Global Impression of Change [CGI-C] scales)

Source: https://euclinicaltrials.eu/ctis-public/view/2023-506301-20-00